EU clinical trial 2024-518936-36-00: Phase IV, randomized, open-label, open-label, controlled, parallel, multicenter clinical trial in patients who are candidates for smoking cessation to evaluate the safety and efficacy of citisinicline maintenance therapy.
Protocol code: CITISILONG
Sponsor: Fundacion Publica Galega Instituto De Investigacion Sanitaria De Santiago De Compostela (Hospital/Clinic/Other health care facility). Phase: Therapeutic use (Phase IV). Countries: Spain (authorised, recruiting).
Therapeutic area(s): Diseases [C] - Respiratory Tract Diseases [C08]
Gender: Female, Male. Age: 18-64 years, 65+ years. Enrolment: 400.
Status: Authorised, recruiting. Start date (EU): 2026-01-23. Decision date: 2025-05-05. Results received: No. Last updated: 2025-08-21.

Condition(s): Active smokers
Product: Recigarum 1,5 mg comprimidos recubiertos con película EFG

Primary endpoint: It will be carried out by evaluating punctual and continuous abstinence at 3, 6 and 12 months., The safety results will be carried out by evaluating the incidence of the side effects foreseen in the technical data sheet.

Source: https://euclinicaltrials.eu/ctis-public/view/2024-518936-36-00